EU clinical trial 2022-501507-27-00: "TOPOLOGY" : A phase II study to evaluate the efficacy and toxicities of PLX038, in patients with locally advanced or metastatic triple-negative breast cancer
Protocol code: IC 2020-16
Sponsor: Institut Curie (Laboratory/Research/Testing facility). Phase: Therapeutic exploratory (Phase II). Countries: France (ended).
Therapeutic area(s): Diseases [C] - Neoplasms [C04]
Gender: Female, Male. Age: 18-64 years, 65+ years. Enrolment: 44.
Status: Ended. Start date (EU): 2024-04-17. End date (EU): 2025-05-15. Decision date: 2023-10-27. Results received: Yes. Last updated: 2025-12-17.

Condition(s): Advanced or metastatic triple-negative breast cancer
Product: PLX038

Primary endpoint: Best tumor response (defined as PR or CR in the first 6 months of treatment, assessed by investigators per RECIST v1.1 criteria)
Endpoint(s): Time to response (TTR), Duration of Response (DoR), Progression free survival (PFS) and Overall Survival (OS), AEs and SAEs (all grade, per NCI-CTCAE v5.0), Association between PLX038 efficacy and homologous recombination (HR) defect (assessed by HR genes mutational status and BCRAness phenotype), replication stress-related biomarkers such as SFLN11 expression, RB1 loss, PK/PD analysis, Exploratory: Association between PLX038 efficacy and tumor or blood biomarkers., Exploratory: Centrally determined ORR and PFS.

Source: https://euclinicaltrials.eu/ctis-public/view/2022-501507-27-00